EU clinical trial 2023-504471-25-00: An Open-label Extension Study of Inhaled Treprostinil in Subjects with Fibrotic Lung Disease
Protocol code: RIN-PF-302
Sponsor: United Therapeutics Corp. (Pharmaceutical company). Phase: Therapeutic confirmatory (Phase III). Countries: Italy (ongoing, recruiting), Belgium (ongoing, recruiting), Netherlands (ongoing, recruitment ended), Spain (ongoing, recruiting), Denmark (ongoing, recruitment ended), France (ongoing, recruiting), Germany (ongoing, recruiting).
Therapeutic area(s): Diseases [C] - Respiratory Tract Diseases [C08]
Gender: Female, Male. Age: 18-64 years, 65+ years. Enrolment: 319.
Start date (EU): 2024-03-01. Decision date: 2023-10-12. Results received: No. Last updated: 2026-06-24.
Decision dates by country: NL: 2023-10-13, ES: 2023-10-16, BE: 2023-10-13, DK: 2023-10-12, FR: 2023-10-13, DE: 2024-10-02, IT: 2023-10-13

Condition(s): Fibrotic Lung Disease
Product: Treprostinil

Primary endpoint: Efficacy will be assessed by evaluating the effect of continued long-term therapy with inhaled Treprostinil on the following parameters: 1. Change in absolute FVC, 2. Time to clinical worsening (including time to death, respiratory hospitalization, or ≥10% relative decline in % predicted FVC), 3. Time to acute exacerbation of IPF or ILD, 4. Overall survival, 5. Change in % predicted FVC, 6. Change in K-BILD score, 7. Change in N-terminal pro-brain natriuretic peptide, 8. Change in DLCO, 9. Change in resting supplemental oxygen use, SAFETY ENDPOINTS Safety will be assessed by reviewing the following parameters: • AEs and serious adverse events (SAEs) • Clinical laboratory parameters •Vital signs, including resting saturation of peripheral capillary oxygenation (SpO2) • 12-lead electrocardiograms (ECGs)

Source: https://euclinicaltrials.eu/ctis-public/view/2023-504471-25-00